EU clinical trial 2023-507591-44-00: Open-Label Safety, Pharmacokinetic, and Efficacy Trial of Sebetralstat (KVD900) in Pediatric Patients (Ages 2-11) with Hereditary Angioedema Type I or II
Protocol code: KVD900-303
Sponsor: Kalvista Pharmaceuticals Limited (Pharmaceutical company). Phase: Therapeutic confirmatory (Phase III). Countries: Italy (ended), Germany (ended), France (ended).
Therapeutic area(s): Diseases [C] - Hemic and Lymphatic Diseases [C15]
Gender: Female, Male. Age: 0-17 years. Enrolment: 14.
Status: Ended. Start date (EU): 2024-10-24. End date (EU): 2026-01-15. End date: 2026-01-16. Decision date: 2024-08-23. Results received: Yes. Last updated: 2025-12-19.
Decision dates by country: IT: 2024-08-23, FR: 2024-09-05, DE: 2024-08-29

Condition(s): Hereditary Angioedema Type I or II
Product: KVD900, KVD900

Primary endpoint: The proportion of pediatric patients with HAE Types I or II who take any sebetralstat dose, who experience any AE(s) (including fatal AEs) during the study, irrespective of uses of other medications and sebetralstat discontinuations for any reason.
Endpoint(s): CaGI-C: Time to beginning of symptom relief defined as at least “a little better” (2 time points in a row) within 12 hours of the first IMP administration., CaGI-S: Time to first incidence of decrease from baseline (2 time points in a row) within 12 hours of the first IMP administration., CaGI-S: Time to HAE attack resolution defined as “none” within 24 hours of the first IMP Administration, Time to use of conventional on-demand treatment within 12 hours of the first IMP administration.

Source: https://euclinicaltrials.eu/ctis-public/view/2023-507591-44-00